EU clinical trial 2023-509696-17-00: An open-label, prospective, single centre study of the effects of Riociguat on RIght VEntricular size and function in Pulmonary Arterial Hypertension and Chronic Thromboembolic Pulmonary Hypertension
Protocol code: 2020-06RCT
Sponsor: Thoraxklinik Heidelberg gGmbH (Hospital/Clinic/Other health care facility). Phase: Therapeutic use (Phase IV). Countries: Germany (ended).
Therapeutic area(s): Diseases [C] - Cardiovascular Diseases [C14]
Gender: Female, Male. Age: 18-64 years, 65+ years. Enrolment: 30.
Status: Ended. Start date (EU): 2021-11-05. End date (EU): 2025-08-13. Decision date: 2024-08-09. Results received: Yes. Last updated: 2025-04-03.

Condition(s): Chronic Thromboembolic Pulmonary Hypertension, Pulmonary Arterial Hypertension
Product: Riociguat Bayer, Riociguat Bayer, Riociguat Bayer, Riociguat Bayer, Riociguat Bayer

Primary endpoint: the change in RV and RA area from baseline to week 24
Endpoint(s): RA and RV area (12 weeks) (echocardiography), Systolic pulmonary artery pressure (sPAP) (echocardiography), RV fractional area change (FAC) (echocardiography), Peak velocity of tricuspid regurgitation (TRV) (echocardiography), Inferior vena cava (IVC) diameter and IVC collapse (echocardiography), Right Ventricle Outflow Tract Velocity Time Integral (RVOT VTI) (echocardiography), Eccentricity index (EI) (echocardiography), Tricuspid Annular Plane Systolic Excursion (TAPSE) (echocardiography), Right and left ventricular pump function (qualitative) (echocardiography), Left Atrial (LA) diameter (echocardiography), LV diastolic function (LV transmitral E wave and A wave, E’ wave of interventricular septum and lateral wall pulsed tissue Doppler, isovolumic relaxation time, mitral deceleration time), Diameters of pulmonary artery (echocardiography), CI in litres per minute per square meter (of body surface area) (RHC), CO in litres per minute (RHC), sPAP, dPAP, mPAP in mmHg (RHC), PAWP in mmHg (RHC), right atrial pressure (RAP) in mmHg (RHC), PVR in Wood Units (RHC), Central venous saturation, via blood gas analysis from pulmonary artery, in % (RHC), 6-minute walking distance from baseline to 12 and 24 weeks of treatment, forced vital capacity (FVC) (Body plethysmography), forced expiratory volume in one second (FEV1) (Body plethysmography), FEV1% of maximal vital capacity (VC max) (Body plethysmography), total lung capacity (TLC) (Body plethysmography), residual volume (Body plethysmography), diffusion-limited carbon monoxide (DLCO) and DLCO/VA (Krogh) factor (Diffusion capacity), partial pressure of oxygen and carbon dioxide (blood gas analysis), SaO2 (blood gas analysis), pH values (blood gas analysis), Blood pressure and heart rate (Cardiopulmonary exercise testing), workload (Cardiopulmonary exercise testing), oxygen consumption as total and per kg body weight (Cardiopulmonary exercise testing), exhaled carbon dioxide (VCO2) (Cardiopulmonary exercise testing), oxygen saturation (Cardiopulmonary exercise testing), oxygen pulse (Cardiopulmonary exercise testing), minute ventilation (Cardiopulmonary exercise testing), respiratory equivalents for oxygen and carbon dioxide (Cardiopulmonary exercise testing), respiratory reserve (all values at rest, anaerobic threshold and peak workload) (Cardiopulmonary exercise testing), NT-proBNP, hemoglobin, hematocrit, AST, ALT, bilirubin, CRP, Sodium, Urea, Creatinine, plasma drug concentration of PAH-targeted drugs including riociguat and endothelin receptor antagonists, WHO functional class from baseline to 12 and 24 weeks of treatment, Quality of life parameters by questionnaire SF-36 from baseline value to 24 weeks of treatment, Tolerability, safety and survival (Adverse events; vital signs [BP, HR, SaO2], ECG; Need for rescue medication safety parameters)

Source: https://euclinicaltrials.eu/ctis-public/view/2023-509696-17-00